EU clinical trial 2025-521573-14-00: Serial cardiac magnetic resonance imaging (CMR) with contrast agents and biomarker analysis for the detection of cardiotoxicity under anthracycline-containing cancer therapy - A monocentric, low interventional Phase IV pilot study
Protocol code: S00854
Sponsor: Robert Bosch Gesellschaft fuer medizinische Forschung mbH (Hospital/Clinic/Other health care facility). Phase: Therapeutic use (Phase IV). Countries: Germany (ongoing, recruiting).
Therapeutic area(s): Analytical, Diagnostic and Therapeutic Techniques and Equipment [E] - Diagnosis [E01]
Gender: Female, Male. Age: 18-64 years, 65+ years. Enrolment: 93.
Status: Ongoing, recruiting. Start date (EU): 2026-03-04. Decision date: 2025-08-08. Results received: No. Last updated: 2025-12-11.

Condition(s): Anthracycline-based antineoplastic therapy (standard of care/routine treatment)
Product: PIXANTRONE, IDARUBICIN, DOXORUBICIN, EPIRUBICIN, MITOXANTRONE, DAUNORUBICIN

Primary endpoint: Changes in the T2-weighted relaxation time in myocardial mapping
Endpoint(s): Further abnormal CMR findings (morphology, function, perfusion, LGE and residual parametric mapping (T1-weighted relaxation time, extracellular volume)) during and after completion of anthracycline-based chemotherapy, analyzed by two different investigators, Troponin T and NT-proBNP before, during and after completion of anthracycline-based chemotherapy in correlation with CMR results, Echocardiographically determined Global Longitudinal Strain before, during and after completion of anthracycline-based chemotherapy in correlation to CMR results, Validation and/or identification of new biomarkers (e.g. genetic markers) using the biomaterials

Source: https://euclinicaltrials.eu/ctis-public/view/2025-521573-14-00